EU clinical trial 2023-505302-42-00: BEPCOME-MB: Phase 2, randomised trial testing the addition of upfront stereotactic radiosurgery to binimetinib, encorafenib plus pembrolizumab in comparison with binimetinib, encorafenib plus pembrolizumab alone in patients with BRAFV600 mutationpositive melanoma with brain metastasis
Protocol code: UC-0107/1810
Sponsor: Unicancer (Hospital/Clinic/Other health care facility). Phase: Therapeutic exploratory (Phase II). Countries: France (ongoing, recruitment ended).
Therapeutic area(s): Diseases [C] - Neoplasms [C04]
Gender: Female, Male. Age: 18-64 years, 65+ years. Enrolment: 150.
Status: Ongoing, recruitment ended. Start date (EU): 2022-09-05. Decision date: 2024-02-01. Results received: No. Last updated: 2025-04-07.

Condition(s): BRAF(V600) mutation-positive melanoma with brain metastasis (MBM)
Product: Mektovi 15 mg film-coated tablets, KEYTRUDA 25 mg/mL concentrate for solution for infusion, Braftovi 75 mg hard capsules

Primary endpoint: Intracranial progression-free survival defined as the time from randomisation until IC-progressive disease (PD) as evaluated by centralised assessment using modified response evaluation criteria in solid tumours version 1.1 (RECIST v1.1), or death, whichever occurs first.
Endpoint(s): Intracranial-response rate, defined as the percentage of patients with a confirmed IC-complete response (CR) or IC-partial response (PR) as assessed by the investigator using modified RECIST v1.1., Intracranial disease control, defined as the percentage of patients with an IC-CR or IC-PR or stable intracranial disease as assessed by the investigator using modified RECIST v1.1., Extracranial response rate, defined as the percentage of patients with a confirmed EC-CR or EC-PR assessed by the investigator using RECIST v1.1., Overall response rate, defined as the percentage of patients with a confirmed CR or PR as assessed by the investigator using modified RECIST v1.1 to assess IC-response and RECIST v1.1 for EC-response., Duration of intracranial, extracranial, and overall response, defined as the time from first observation of, IC-, EC-, or overall response respectively (i.e. CR or PR), until PD according to modified RECIST v1.1 (intracranial disease) or RECIST v1.1 (extracranial disease) or death, whichever occurs first., Duration of response of treated target lesions, defined as the time from first documented response (i.e. CR or PR) as assessed by the investigator using modified RECIST v1.1, until PD of treated target lesions or death, whichever occurs first., Progression-free survival, defined as the time from randomisation until IC-PD according to modified RECIST v1.1, EC-PD according to RECIST v1.1, as assessed by the investigator, or death, whichever occurs first., Overall survival, defined as the time from randomisation until death due to any cause., Health Related Quality of Life assessed using the European Organisation for Research and Treatment of Cancer (EORTC) quality of life questionnaires (QLQ-C30 and BN20)., Cognitive performance assessed using the Montreal Cognitive Assessment (MoCA)., Frequency and severity of adverse events assessed according to NCI-CTCAE v5.0., Other skin, laboratory, vital-sign, cardiac function, and neurological assessment data.

Source: https://euclinicaltrials.eu/ctis-public/view/2023-505302-42-00